EU clinical trial 2025-524663-20-00: A Randomized, Open label, Single Center, Single Oral Dose, Four Treatment, Four Period, Four Sequence, Crossover Bioavailability Study of Haleon Immediate Release Tablets 2X (paracetamol/naproxen 500 mg/125 mg) vs. Panadol Advance Tablets 2X (paracetamol 500 mg), Naprosyn Tablets 1X (naproxen 250 mg), administered individually in fasted conditions and Haleon Immediate Release Tablets 2X (paracetamol/naproxen 500 mg/125 mg) in fed conditions in Healthy Adult Participants
Protocol code: 300259
Sponsor: Haleon CH SARL (Pharmaceutical company). Phase: Human Pharmacology (Phase I)- Other. Countries: Germany (authorised, recruitment pending).
Therapeutic area(s): Not possible to specify
Gender: Female, Male. Age: 18-64 years. Enrolment: 52.
Status: Authorised, recruitment pending. Decision date: 2026-08-06. Results received: No. Last updated: 2026-08-06.

Condition(s): Healthy volunteers, therapeutic indication not studied
Product: Panadol Advance 500 mg Tablets, Paracetamol 500 mg and Naproxen 125mg Tablet MFC-06285, Naprosyn 250 mg comprimidos

Primary endpoint: AUC0-tlast, Cmax for paracetamol and naproxen after fasted administration of Test vs. Reference 1 and Test vs. Reference 2, respectively
Endpoint(s): AUC0-tlast, Cmax and tmax for paracetamol and naproxen after administration of Test under fasted vs. Test under fed conditions, Tmax for paracetamol and naproxen after fasted administration of Test vs. Reference 1 and Test vs. Reference 2, respectively, Pharmacokinetic parameters (tmax, AUC0-inf, %AUCex, λz, t1/2 ) for paracetamol after fasted administration of Reference 1, Pharmacokinetic parameters (tmax, AUC0-inf, %AUCex, λz, t1/2 ) for naproxen after fasted administration of Reference 2, Pharmacokinetic parameters (tmax, AUC0-inf, %AUCex, λz, t1/2 ) for paracetamol and naproxen after administration of Test, under fasted and fed condition, Tolerability assessment based on AEs, vital signs and protocol-specified safety labs for Test and Reference treatments.

Source: https://euclinicaltrials.eu/ctis-public/view/2025-524663-20-00